EU clinical trial 2022-501349-64-00: A Phase 2, Double-Blind, 12 Week, Multicenter Study to Assess the Safety and Effectiveness of Daily Oral Administration of Dexlansoprazole Delayed-Release Capsules in Pediatric Subjects Aged 2 to 11 Years With Symptomatic Nonerosive Gastroesophageal Reflux Disease
Protocol code: TAK-390MR_204
Sponsor: Takeda Development Center Americas Inc. (Pharmaceutical company). Phase: Therapeutic exploratory (Phase II). Countries: Poland (ended).
Therapeutic area(s): Diseases [C] - Digestive System Diseases [C06]
Gender: Female, Male. Age: 0-17 years. Enrolment: 20.
Status: Ended. Start date (EU): 2026-01-12. End date (EU): 2026-06-23. End date: 2026-07-21. Decision date: 2024-04-05. Results received: No. Last updated: 2025-05-20.

Condition(s): Symptomatic nonerosive GERD in paediatric subjects aged 2 to 11 years
Product: DEXLANSOPRAZOLE PEDIATRIC, DEXLANSOPRAZOLE PEDIATRIC, DEXLANSOPRAZOLE PEDIATRIC

Primary endpoint: The percentage of days without hurting or burning in the stomach, chest or throat over the 12 weeks of treatment.
Endpoint(s): Percentage of days without hurting or burning in the stomach, chest or throat in children aged 9 to 11 years over the 12 weeks of treatment., Percentage of days without hurting or burning in the stomach, chest or throat in children aged 2 to 8 years over the 12 weeks of treatment., Percentage of days without vomiting over the 12 weeks of treatment., Percentage of days food did not come up from stomach to mouth over the 12 weeks of treatment., Percentage of days without trouble eating over the 12 weeks of treatment., Comparison of the difference of the mean percentage of days without hurting or burning in the stomach, chest, or throat over the 12 weeks of treatment between the high dose and the low dose within each weight strata.

Source: https://euclinicaltrials.eu/ctis-public/view/2022-501349-64-00